EU clinical trial 2023-504426-19-00: A Phase 1, Randomized, Double-Blind, Placebo-Controlled, Safety, Tolerability and Pharmacokinetic Study of Escalating Single and Multiple Doses of GTX-11 in Healthy Subjects
Protocol code: GTX-PH1-001
Sponsor: Gat Therapeutics S.L. (Pharmaceutical company). Phase: Human Pharmacology (Phase I)- First administration to humans. Countries: Spain (ended).
Therapeutic area(s): Diseases [C] - Respiratory Tract Diseases [C08]
Gender: Female, Male. Age: 18-64 years. Enrolment: 52.
Status: Ended. Start date (EU): 2024-10-01. End date (EU): 2025-10-12. Decision date: 2023-11-27. Results received: No. Last updated: 2025-01-03.

Condition(s): Pulmonary fibrosis

Source: https://euclinicaltrials.eu/ctis-public/view/2023-504426-19-00